EU clinical trial 2024-518678-16-00: MOTHER trial: Efficacy and safety of low-dose intrathecal morphine following planned caesarean section - a randomised, blinded, clinical, controlled, multicentre trial.
Sponsor: Region Sjaelland (Hospital/Clinic/Other health care facility). Phase: Therapeutic use (Phase IV). Countries: Denmark (ongoing, recruiting).
Therapeutic area(s): Analytical, Diagnostic and Therapeutic Techniques and Equipment [E] - Anesthesia and Analgesia [E03]
Gender: Female. Age: 18-64 years. Enrolment: 1312.
Status: Ongoing, recruiting. Start date (EU): 2025-07-08. Decision date: 2025-05-05. Results received: No. Last updated: 2026-02-06.

Condition(s): Caesarean section, acute postoperative pain
Product: MORPHINE HYDROCHLORIDE, Sodium chloride 9 mg/ml (solution for injection)

Primary endpoint: Level of pain when mobilising from supine to sitting position within 24 hours: Level of pain when mobilising from supine to sitting position within 24 hours, Maternal and neonatal safety: Binary composite outcome consisting of 1) participants with respiratory depression 2) participants with severe nausea/vomiting within 24 hours 3) neonatal admission within 48 hours 4) hospitalisation of participant or neonate within 7 days after discharge and 5) death of either participant or neonate within 7 days
Endpoint(s): Opioid consumption within 24 hours, Morphine associated adverse events within 24 hours: Vomiting, nausea, dizziness, pruritus and urinary retention, Obstetric quality of recovery score at 24 hours, Participants satisfaction with postoperative pain-treatment during the first 24 hours, Established breastfeeding at 30 days

Source: https://euclinicaltrials.eu/ctis-public/view/2024-518678-16-00